EU clinical trial 2023-508341-40-00: COACH: A Phase 2, Open-Label, 156-week Trial to Investigate the Efficacy, Safety and Tolerability of Once Weekly Navepegritide and Lonapegsomatropin in Children with Achondroplasia
Protocol code: ASND0042
Sponsor: Ascendis Pharma Growth Disorders A/S (Pharmaceutical company). Phase: Therapeutic exploratory (Phase II). Countries: Denmark (ongoing, recruitment ended), Ireland (ongoing, recruitment ended).
Therapeutic area(s): Diseases [C] - Musculoskeletal Diseases [C05]
Gender: Female, Male. Age: 0-17 years. Enrolment: 10.
Status: Ongoing, recruitment ended. Start date (EU): 2024-07-26. Decision date: 2024-04-23. Results received: No. Last updated: 2026-07-16.
Decision dates by country: DK: 2024-04-23, IE: 2024-04-29

Condition(s): Children with Achondroplasia
Product: Navepegritide 2.8 mg CNP(89-126), TransCon hGH, Navepegritide 5.5 mg CNP(89-126), TransCon hGH, TransCon CNP 3.9 mg CNP-38/vial

Primary endpoint: AGV (cm/year) (Week 52), TEAEs
Endpoint(s): AGV (cm/year) (Week 52), AGV (cm/year) (Weeks 26 and 104). Change from baseline in height Z-score (Weeks 13, 26, 52 and 104). Change from baseline in AGV (Weeks 26, 52 and 104), Change from baseline in the following AEMs (Weeks 26, 52, 104): Achondroplasia Child Experience. ACEM-OSM. ACEM-Impact. APEM, Change from baseline in the following COAs (Weeks 26, 52 and 104). QoLISSY. SF-10. PGIS. PGIC. HCRU. CGI-S, Change from baseline in upper to lower body segment ratio (Weeks 26, 52, and 104). Change from baseline in arm span and ACH-specific arm span Z-score (Weeks 26, 52, and 104). Change from baseline in other anthropomorphic measurements, including upper arm length, lower arm length, upper leg length, lower leg length (Weeks 26, 52, and 104), Change from baseline in length of long bones (e.g., femur, humerus, tibia, fibula, tibia/fibula ratio), vertebral column (cobb angles, vertebral posterior element morphometry, vertebral body morphometry, spinal height), and other measurments (mechanical axis lines) using standardized radiologic assessment (Weeks 52, and 104), Change from baseline in percent fat, mass and percent lean mass using DXA assessment (Weeks 52, and 104), Change from baseline in number of rises during a 1-MSTST (Weeks 52,and 104). Change from baseline in maximal knee extensor muscle strength (Weeks 52, and 104), Safety assessments throughout the trial (Vital signs, ECG, safety laboratory tests, physical and skeletal examinations, injection site reactions, and fundoscopy). Bone age to chronological age ratio, and bone age Z-score (Weeks 26, 52, and 104). Bone mineral density (Weeks 52 and 104)), Plasma concentration of Total CNP, Free CNP and mPEG. Serum concentrations of hGH and lonapegsomatropin, Serum concentrations of IGF-1 and IGFBP3, Detection and characterisation of both antidrug and anti-prodrug antibodies

Source: https://euclinicaltrials.eu/ctis-public/view/2023-508341-40-00